EU clinical trial 2023-506997-11-00: A trial to learn if AZD9829 is safe and works alone and in combination with other treatments for participants with certain blood cancers.
Protocol code: D9470C00001
Sponsor: Astrazeneca AB (Pharmaceutical company). Phase: Human Pharmacology (Phase I)- First administration to humans. Countries: Spain (ended), Italy (ended), Germany (ended).
Therapeutic area(s): Diseases [C] - Hemic and Lymphatic Diseases [C15]
Gender: Female, Male. Age: 18-64 years, 65+ years. Enrolment: 14.
Status: Ended. Start date (EU): 2024-10-09. End date (EU): 2026-02-24. End date: 2026-02-25. Decision date: 2024-05-07. Results received: No. Last updated: 2026-03-05.
Decision dates by country: IT: 2024-05-09, DE: 2024-05-07, ES: 2024-05-10

Condition(s): CD123-Positive Hematological Malignancies: Module 1 focuses on R/R Acute Myeloid Leukemia and R/R Myelodysplastic Syndrome.

Source: https://euclinicaltrials.eu/ctis-public/view/2023-506997-11-00